EU clinical trial 2023-507808-31-00: Evaluation of the Eleveld Pharmacokinetic Model for Propofol and Remifentanil in Cardiac Anesthesia with Cardiopulmonary Bypass
Protocol code: ELEVALUATE
Sponsor: Medical University of Vienna (Educational Institution). Phase: Therapeutic use (Phase IV). Countries: Austria (ongoing, recruiting).
Therapeutic area(s): Analytical, Diagnostic and Therapeutic Techniques and Equipment [E] - Anesthesia and Analgesia [E03]
Gender: Female, Male. Age: 18-64 years, 65+ years. Enrolment: 100.
Status: Ongoing, recruiting. Start date (EU): 2025-02-16. Decision date: 2024-04-29. Results received: No. Last updated: 2024-04-29.

Condition(s): Valvular heart disease; coronary heart disease; aortic disorders;
Product: Propofol „Fresenius" 2 % mit MCT - Emulsion zur Injektion oder Infusion, Ultiva 5 mg Pulver für ein Konzentrat zur Herstellung einer Injektions-/Infusionslösung, Remifentanil-hameln 5 mg Pulver für ein Konzentrat zur Herstellung einer Injektions-/ Infusionslösung

Primary endpoint: The primary endpoint is the median prediction error (MDPE) for propofol and remifentanil concentrations.
Endpoint(s): The agreement between measured and predicted propofol and remifentanil concentrations will be evaluated using Bland-Altman analysis., The median absolute prediction error (MDAPE) will be calculated for propofol and remifentanil. An MDAPE <30% is considered clinically acceptable, The intraoperative area under the curve (AUC) for estimated and measured propofol and remifentanil concentrations will be compared. A difference of 20% will be considered clinically acceptable., The BIS value at each sampling time point will be recorded. BIS values will be plotted against CE of propofol and SEVET to describe the distribution of BIS values at each CE and SEVET, BIS, SEF, SR and ST values will be recorded continuously. Descriptive statistics will be used to describe the percentage of time the BIS, SEF, SR and ST values were within the target range throughout anesthesia., Descriptive statistics will be used to report the range of NOL values at each sampling time point. NOL values will be plotted against CE of remifentanil to describe the distribution of NOL values at each CE of remifentanil., Descriptive statistics will be used to report the range of PPI values at each sampling time point. PPI values will be plotted against CE of remifentanil to describe the distribution of PPI values at each CE of remifentanil., The agreement between analgesic depth provided by NOL® and PPI will be evaluated using Bland-Altman analysis., After stratification for gender, MDPE and MDAPE will be compared between male and female patients (Mann-Whitney-U test).

Source: https://euclinicaltrials.eu/ctis-public/view/2023-507808-31-00